EU clinical trial 2025-524977-18-00: Phase I/II Trial to Determine Safety and Efficacy of non-Viral Allogeneic Dual CD123/33-Chimeric Antigen Receptor CIK (CARCIK-CD123/33) Cells in Adult and Pediatric Patients with Relapse/Refractory Acute Myeloid Leukemia (AML) and Blastic Plasmacytoid Dendritic Cell Neoplasm (BPDCN)
Sponsor: Fondazione Tettamanti, Fondazione IRCCS San Gerardo Dei Tintori (Laboratory/Research/Testing facility, Hospital/Clinic/Other health care facility). Phase: Phase I and Phase II (Integrated)- First administration to humans. Countries: Italy (authorised, recruitment pending).
Therapeutic area(s): Diseases [C] - Neoplasms [C04]; Diseases [C] - Hemic and Lymphatic Diseases [C15]
Gender: Female, Male. Age: 0-17 years, 18-64 years, 65+ years. Enrolment: 18.
Status: Authorised, recruitment pending. Decision date: 2026-07-27. Results received: No. Last updated: 2026-07-27.

Condition(s): Acute myeloid leukemia and Blastic plasmacytoid dendritic cell neoplasm
Product: CARCIK CD123/33

Primary endpoint: Rate of enrolled patients that eventually receive CARCIK-CD123/33 infusion, Rate of dose Limiting toxicity (DLT) as per investigator assessment during the first 28 days after CARCIK-CD123/33 infusion, Incidence of Adverse event (AE) and laboratory abnormalities continuously assessed throughout the study and reported at each scheduled visit
Endpoint(s): Investigator-assessed overall response rate (CR+CRh+CRi+MLFS+PR) at 28 days after the first CARCIK-CD123/33 infusion, Persistence and kinetics of CARCIK-CD123/33 cells in terms of absolute number of cells using flowcytometry and vector copy number (VCN) by polymerase chain reaction (PCR), in target tissues, Persistence and kinetics of peripheral blood lymphoid chimerism, Investigator assessed best objective response (CR+CRh+CRi+MLFS+PR) after CARCIK-CD123/33 infusion, according to the defined criteria above, DOR, calculated as time from first documentation of a response to relapse, new anticancer therapies, progression or death from any cause, DFS, defined as time from first documentation of a CR to relapse, new anticancer therapies or death from any cause, PFS, defined as the time from CARCIK-CD123/33 infusion until leukemia progression, new anticancer therapies or leukemia-related death, OS, calculated as time from CARCIK-CD123/33 infusion to death from any cause

Source: https://euclinicaltrials.eu/ctis-public/view/2025-524977-18-00